EU clinical trial 2024-518718-14-00: A Multicenter, Randomized, Double-blind, Placebo-controlled, Phase 2b/3 Study to Evaluate the Efficacy and Safety of Saroglitazar Magnesium in Subjects with Primary Biliary Cholangitis
Protocol code: SARO.21.001
Sponsor: Zydus Therapeutics Inc. (Pharmaceutical company). Phase: Phase II and Phase III (Integrated). Countries: Iceland (ended).
Therapeutic area(s): Diseases [C] - Immune System Diseases [C20]
Gender: Female, Male. Age: 18-64 years, 65+ years. Enrolment: 6.
Status: Ended. Start date (EU): 2023-01-23. End date (EU): 2025-05-07. Decision date: 2024-12-20. Results received: Yes. Last updated: 2025-05-15.

Condition(s): Primary Biliary Cholangitis (PBC)
Product: The comparator will be Placebo, which will be formulated as tablets, and will contain the protocol mentioned excipients without Saroglitazar Magnesium Micronized, Saroglitazar Magnesium

Primary endpoint: Proportion of subjects with a biochemical response based on the composite endpoints of ALP and total bilirubin [ALP < 1.67 x ULN, ≥ 15% decrease in ALP relative to baseline, and total bilirubin ≤ ULN or direct bilirubin ≤ ULN in subjects with known Gilbert’s syndrome] at Week 52.
Endpoint(s): Proportion of subjects with complete normalization of ALP defined as (ALP≤ULN) at Week 52., Change from baseline in 5-D itch score at Week 24 and Week 52 in subjects with baseline 5-D itch score of ≥ 12, Proportion of subjects with a biochemical response based on the composite endpoints of ALP and total bilirubin [ALP < 1.67 x ULN, ≥ 15% decrease in ALP, and total bilirubin ≤ ULN or direct bilirubin ≤ ULN in subjects with known Gilbert’s syndrome] at Weeks 4, 8, 16, and 24., Proportion of subjects with ALP improvement of at least 15%, 30%, 40%, and 50% at Weeks 24 and 52. • Absolute and percent change from baseline in ALP values at Weeks 24 and 52., Change from baseline in quality of life (PBC 40) questionnaire domains (total score and domain score) at Weeks 16, 24, and 52., Proportion of subjects with a decrease in LSM of at least 25% at Weeks 24 and Week 52 relative to baseline, Change from baseline in liver enzyme parameters (ALT, AST, GGT, and total bilirubin [direct and indirect bilirubin]) at Weeks 16, 24, and 52. • Change from baseline in lipid parameters (TG, LDL-C, HDL-C, VLDL-C, total cholesterol, and non-HDL-C) at Weeks 24 and 52.Change from baseline in serum bile acids at Weeks 24 and 52.

Source: https://euclinicaltrials.eu/ctis-public/view/2024-518718-14-00